EU clinical trial 2024-516336-97-00: “NALPAC” A NON-COMPARATIVE RANDOMIZED PHASE 2 STUDY, EVALUATING THE EFFICACY OF 5-FU + NALIRI AND 5-FU + NALIRINOX FOR METASTATIC PANCREATIC DUCTAL ADENOCARCINOMA (PDAC), PROGRESSIVE AFTER GEMCITABINE-ABRAXANE OR GEMCITABINE MONOTHERAPY.
Protocol code: NALPAC
Sponsor: Groupe Belge D'Oncologie Digestive (Hospital/Clinic/Other health care facility). Phase: Therapeutic exploratory (Phase II). Countries: Belgium (ongoing, recruiting).
Therapeutic area(s): Diseases [C] - Digestive System Diseases [C06]
Gender: Female, Male. Age: 18-64 years, 65+ years. Enrolment: 134.
Status: Ongoing, recruiting. Start date (EU): 2022-02-21. Decision date: 2024-09-11. Results received: No. Last updated: 2025-02-25.

Condition(s): METASTATIC PANCREATIC DUCTAL ADENOCARCINOMA
Product: Fluorouracil Accord Healthcare 50 mg/ml oplossing voor injectie of infusie, Onivyde pegylated liposomal 4.3 mg/ml concentrate for dispersion for infusion, Fluorouracil Accord Healthcare 50 mg/ml oplossing voor injectie of infusie, Levofolic 50 mg/ml oplossing voor injectie / infusie, Oxaliplatin Accord Healthcare 5 mg/ml concentraat voor oplossing voor infusie, Oxaliplatin Accord Healthcare 5 mg/ml concentraat voor oplossing voor infusie, Levofolic 50 mg/ml oplossing voor injectie / infusie, Fluorouracil Accord Healthcare 50 mg/ml oplossing voor injectie of infusie, Oxaliplatin Accord Healthcare 5 mg/ml concentraat voor oplossing voor infusie, ELVORINE 25 mg/2,5 mL, solution injectable, Fluorouracil Accord Healthcare 50 mg/ml oplossing voor injectie of infusie, Levofolic 50 mg/ml oplossing voor injectie / infusie, ELVORINE 50 mg/5 mL, solution injectable, Fluorouracil Accord Healthcare 50 mg/ml oplossing voor injectie of infusie

Primary endpoint: PFSR is defined as the proportion of patients alive and free of progression at day 85. Patients who do not progress are considered achieving either a stable disease (SD), a partial response (PR) or a complete response (CR) at day 85, according to RECIST 1.1 criteria. Patients who are unable to be evaluated at day 85, due to rapid clinical deterioration or death from any cause or start of an additional anti-tumor therapy, will be considered as progressive disease (PD).
Endpoint(s): Safety/toxicity and tolerability profile: Adverse events, laboratory safety assessment, physical examination, PFS and sensitivity analysis, Objective tumor response according to RECIST v 1.1, Overall survival, Disease control, Duration of response, Exploratory endpoint: Translational analysis on tumor tissue and blood samples

Source: https://euclinicaltrials.eu/ctis-public/view/2024-516336-97-00